EU clinical trial 2022-502275-39-00: A phase 1/phase 2 study to investigate safety, tolerability and efficacy with TG01/QS-21 vaccine administration in patients with confirmed KRAS or NRAS codon 12/13 mutation and high-risk smoldering multiple myeloma or multiple myeloma and evidence of measurable disease ≥ 1 line of treatment.
Protocol code: OMC04
Sponsor: Oslo University Hospital Hf (Hospital/Clinic/Other health care facility). Phase: Phase I and Phase II (Integrated)- Other. Countries: Norway (ongoing, recruitment ended).
Therapeutic area(s): Diseases [C] - Hemic and Lymphatic Diseases [C15]
Gender: Female, Male. Age: 18-64 years, 65+ years. Enrolment: 20.
Status: Ongoing, recruitment ended. Start date (EU): 2023-05-19. Decision date: 2022-12-21. Results received: No. Last updated: 2026-06-11.

Condition(s): multiple myeloma

Source: https://euclinicaltrials.eu/ctis-public/view/2022-502275-39-00